EU clinical trial 2025-521919-39-00: A PK study to compare JPB898 (proposed nivolumab biosimilar) and US-licensed Opdivo® in participants with resected stage IIB, IIC, or III melanoma in the adjuvant setting
Protocol code: CJPB898A12101
Sponsor: H e x a l AG (Pharmaceutical company). Phase: Human Pharmacology (Phase I)- Other. Countries: Spain (ongoing, recruiting), Romania (ongoing, recruiting), Italy (authorised, recruiting), Greece (authorised, recruitment pending).
Therapeutic area(s): Diseases [C] - Neoplasms [C04]
Gender: Female, Male. Age: 18-64 years, 65+ years. Enrolment: 83.
Start date (EU): 2026-02-10. Decision date: 2026-01-27. Results received: No. Last updated: 2026-06-08.
Decision dates by country: IT: 2026-01-27, GR: 2026-05-07, ES: 2026-02-02, RO: 2026-02-02

Condition(s): Resected stage IIB, IIC, or III melanoma requiring adjuvant treatment

Source: https://euclinicaltrials.eu/ctis-public/view/2025-521919-39-00